EU clinical trial 2024-515122-89-00: An open-label pilot study to assess pain experience and usability of different injection techniques and devices for the administration of the purified chick-embryo cell-culture rabies vaccine in children aged 4 to 14 years
Sponsor: Institute Of Tropical Medicine (Hospital/Clinic/Other health care facility). Phase: Phase III and phase IV (Integrated). Countries: Belgium (ongoing, recruiting).
Therapeutic area(s): Diseases [C] - Virus Diseases [C02]
Gender: Female, Male. Age: 0-17 years. Enrolment: 48.
Status: Ongoing, recruiting. Start date (EU): 2025-01-08. Decision date: 2024-10-21. Results received: No. Last updated: 2025-08-13.
Decision dates by country: BE: 2024-11-07

Condition(s): rabies pre-exposure prophylaxis
Product: Rabipur Pulver und Lösungsmittel zur Herstellung einer Injektionslösung in einer Fertigspritze Tollwut-Impfstoff (inaktiviert), RABIPUR, poudre et solvant pour solution injectable en seringue préremplie. Vaccin rabique (inactivé)., Rabipur poeder en oplosmiddel voor oplossing voor injectie in een voorgevulde spuit.Rabiësvaccin (geïnactiveerd).

Primary endpoint: The mean and median score of the Faces Pain Scale-Revised (FPS-R) after each vaccination. The FPS-R is a validated scoring system for the assessment of acute pain in children from 4 years onwards
Endpoint(s): The mean and median score of a Numeric Rating Scale (NRS), as judged by the parent/legal guardian after each vaccination., The mean and median score of a NRS for each aspect of the usability parameters ‘ease of use’ and ‘safety’., Percentage of participants that have rabies antibodies ≥ 0.5 IU/ml on day 28 after the third dose of study vaccine. A titre ≥ 0.5 IU/ml is defined as an adequate seroconversion after vaccination according to WHO standard., Count and percentage of solicited and unsolicited AEs up to day 7 after each vaccination. Categories: mild, moderate, severe., Count and percentage of related and unrelated MAAEs resulting in study discontinuation and SAEs throughout the study period., The mean and median score of the Children’s Fear Score (CFS) after each vaccination., The mean and median score of a Numeric Rating Scale (NRS), as judged by the parent/legal guardian after each vaccination.

Source: https://euclinicaltrials.eu/ctis-public/view/2024-515122-89-00